EU clinical trial 2023-508832-68-00: A Phase 1b/2 Open-Label Trial of Tisotumab Vedotin (HuMax®-TF-ADC) Monotherapy and in Combination with Other Agents in Subjects with Recurrent or Stage IVB Cervical Cancer
Protocol code: GCT1015-05
Sponsor: Genmab A/S (Pharmaceutical company). Phase: Phase I and Phase II (Integrated)- Other. Countries: Czechia (ended), Netherlands (ended), Belgium (ended), Ireland (ended), Spain (ended), Italy (ended).
Therapeutic area(s): Diseases [C] - Neoplasms [C04]
Gender: Female. Age: 18-64 years, 65+ years. Enrolment: 143.
Status: Ended. Start date (EU): 2019-03-28. End date (EU): 2026-03-19. End date: 2026-03-19. Decision date: 2024-04-16. Results received: No. Last updated: 2026-04-20.
Decision dates by country: BE: 2024-04-23, IE: 2024-04-16, IT: 2024-04-19, CZ: 2024-04-18, ES: 2024-04-22, NL: 2024-04-16

Condition(s): Recurrent or stage IVB cervical cancer
Product: HuMax-TF-ADC, CARBOPLATIN, PEMBROLIZUMAB, BEVACIZUMAB

Primary endpoint: Dose escalation: Incidences of dose-limiting toxicities (DLTs), adverse events (AEs), serious adverse events (SAEs), infusion-related AEs, Common Terminology Criteria for Adverse Events (CTCAE) grade ≥3 AEs, and AEs related to trial treatment during the trial, Dose Expansion: ORR per RECIST v1.1
Endpoint(s): AEs and evaluation of safety laboratory parameters, Objective Response Rate (ORR) per RECIST v1.1 (only dose escalation), DOR per RECIST v1.1, TTR per RECIST v1.1, PFS per RECIST v1.1, Overall Survival (OS), PK-concentrations and anti-drug antibodies (ADAs) associated with tisotumab vedotin

Source: https://euclinicaltrials.eu/ctis-public/view/2023-508832-68-00